EU clinical trial 2023-504091-23-00: A Phase II, Single-Arm Study of Giredestrant in Patients with Grade 1 Endometrial Cancer
Protocol code: CO44195
Sponsor: F. Hoffmann-La Roche AG (Pharmaceutical company). Phase: Therapeutic exploratory (Phase II). Countries: Poland (ongoing, recruitment ended), Italy (ended).
Therapeutic area(s): Diseases [C] - Neoplasms [C04]
Gender: Female, Male. Age: 18-64 years, 65+ years. Enrolment: 9.
Start date (EU): 2023-03-14. Decision date: 2024-05-20. Results received: No. Last updated: 2025-10-10.
Decision dates by country: IT: 2024-05-20, PL: 2024-05-20

Condition(s): Grade 1 Endometrial Cancer
Product: RO7197597

Primary endpoint: 1. Regression rate at Month 6 assessment, defined as participants who have a decrease in the proportion of cancer or percentage of cancer is not increased but have an increase in non-cancer/non-atypical hyperplasia (%) at the Month 6 assessment compared with baseline, 2. Occurrence and severity of adverse events with severity determined according to the National Cancer Institute Common Terminology Criteria for Adverse Events (NCI CTCAE) v5.0
Endpoint(s): 1. Complete regression rate, defined as the participants who have an assessment of 100% of non-cancer/non-atypical hyperplasia at Month 6 assessment, 2. Duration of regression, defined as the time from the first regression to time of the first relapse, 3. Time to regression, defined as the time from the first study treatment to the first regression, 4. Time to relapse or loss of clinical benefit per investigator, defined as the time from the first study treatment to relapse or loss of clinical benefit per investigator, whichever occurs first. Participants will be censored if they have surgery at Month 6 and no relapse or loss of clinical benefit occurs before surgery, 5. Plasma concentration of giredestrant at specified timepoints

Source: https://euclinicaltrials.eu/ctis-public/view/2023-504091-23-00